EU clinical trial 2023-506136-32-00: A Phase 1/2 Open-label Study to Investigate the Safety, Efficacy, and Pharmacokinetics of Administration of Subcutaneous Blinatumomab for the Treatment of Adults and Adolescents with Relapsed or Refractory B cell Precursor Acute Lymphoblastic Leukemia (R/R B-ALL) and Minimal Residual Disease Positive (MRD+) B-ALL
Protocol code: 20180257
Sponsor: Amgen Inc. (Pharmaceutical company). Phase: Phase I and Phase II (Integrated)- Other. Countries: Italy (temporarily halted), Germany (temporarily halted), Spain (temporarily halted), Netherlands (temporarily halted), France (temporarily halted), Romania (temporarily halted), Belgium (temporarily halted).
Therapeutic area(s): Diseases [C] - Neoplasms [C04]
Gender: Female, Male. Age: 0-17 years, 18-64 years, 65+ years. Enrolment: 58.
Status: Temporarily halted. Start date (EU): 2020-10-12. Decision date: 2024-01-30. Results received: No. Last updated: 2026-08-07.
Decision dates by country: NL: 2024-01-30, ES: 2024-01-30, RO: 2026-02-09, BE: 2026-01-21, FR: 2024-02-13, IT: 2024-03-11, DE: 2024-01-31

Condition(s): Relapsed or Refractory B cell Precursor Acute Lymphoblastic Leukemia (R/R B-ALL) and Minimal Residual Disease Positive (MRD+) B-ALL,
Product: DEXAMETHASONE, Blinatumomab SC2, LEVETIRACETAM, VINCRISTINE SULFATE, Blinatumomab SC1, METHOTREXATE, CYCLOPHOSPHAMIDE, CYTARABINE

Primary endpoint: Dose escalation - Dose limiting toxicities (DLTs), treatment-emergent adverse events (TEAE), serious TEAE, treatment-related TEAE , and adverse events of interest., Dose expansion - CR/CRh within the first 2 cycles, Phase 2 Ph-IIC (Subcutaneous Formulation 1 [SC1] and Subcutaneous Formulation 2 [SC2] Cohorts) - Blinatumomab PK parameters following SC administration including, but not limited to Cmax, average concentration (Cavg), tmax, and AUC, Phase 2 Ph-IIR (Relapsed/Refractory [R/R] Cohort) - CR/CRh within the first 2 cycles, Phase 2 Ph-IIM (MRD-positive [MRD+] Cohort) - CR with MRD negative response (MRD < 10-4 [0.01%]) within the first 2 cycles
Endpoint(s): Dose escalation - Blinatumomab PK parameters following SC administration including, but not limited to, minimum concentration over the dosing interval (Cmin), maximum concentration (Cmax), time to maximum concentration (Tmax), area under the concentration-time curve (AUC), Dose escalation - Complete remission/complete remission with partial hematological recovery (CR/CRh) within the first 2 cycles, Dose escalation - Anti-blinatumomab antibody formation, Dose Expansion and Phase 2 (Ph-IIR and Ph-IIM cohorts) Blinatumomab PK parameters following SC administration including, but not limited to Cmin, Cmax, Tmax, and AUC, Dose Expansion and Phase 2 (Ph-IIR and Ph-IIM cohorts) Anti-blinatumomab antibody formation, Dose Expansion RFS in subjects who achieve response (CR/CRh within the first 2 cycles) is defined as the time from the first achievement of this response until date of the first relapse including extramedullary relapse, or death due to any cause, whichever occurs first, Dose Expansion and Phase 2 (Ph-IIR and Ph-IIM cohorts) Overall survival (OS) is calculated from the time of the start of first dose of SC blinatumomab until death due to any cause, Dose Expansion -Duration of response and RFS is defined as the time from the first onset of response (CR/CRh within the first 2 cycles) until the hematologic relapse (including EM relapse) or death due to any cause, whichever occurs first, Dose Expansion TEAEs, serious TEAEs, treatment related TEAEs, and adverse events of interest, Dose Expansion and Phase 2 (Ph-IIR and Ph-IIM cohorts) Summary scores at each assessment and change from baseline as assessed by the European Organization for Research and Treatment of Cancer (EORTC) Quality of Life Questionnaire (QLQ C30), Phase 2 Ph-IIC (SC1 and SC2 Cohorts) Complete remission/complete remission with partial hematological recovery (CR/CRh) within the first 2 cycles, Phase 2 Ph-IIC (SC1 and SC2 Cohorts) Anti blinatumomab antibody formation, Phase 2 Ph-IIC (SC1 and SC2 Cohorts) RFS in subjects who achieve response (CR/CRh within the first 2 cycles) is defined as the time from the first achievement of this response until date of the first relapse including extramedullary relapse, or death due to any cause, whichever occurs first, Phase 2 Ph-IIC (SC1 and SC2 Cohorts) OS is calculated from the time of the start of first dose of SC blinatumomab until death due to any cause, Phase 2 Ph-IIC (Subcutaneous Formulation 1 [SC1] and Subcutaneous Formulation 2 [SC2] Cohorts) - • Duration of response and RFS is defined as the time from the first onset of response (CR/CRh within the first 2 cycles) until hematologic relapse (including EM relapse) or death due to any cause, whichever occurs first., Phase 2 Ph-IIC (Subcutaneous Formulation 1 [SC1] and Subcutaneous Formulation 2 [SC2] Cohorts) - TEAEs, serious TEAEs, treatment related TEAEs, and adverse events of interest, Phase 2 Ph-IIC (SC1 and SC2 Cohorts) Summary scores at each assessment and change from baseline as assessed by the European Organization for Research and Treatment of Cancer (EORTC) Quality of Life Questionnaire (QLQ C30), Phase 2 Ph-IIR (Relapsed/Refractory [R/R] Cohort) (Key Secondary) - • CR within first 2 cycles • CR/CRh/CRi/Blast free hypoplastic or aplastic BM within the first 2 cycles, Phase 2 Ph-IIR (Relapsed/Refractory [R/R] Cohort) (Key Secondary) • CR/CRh with MRD negative response (MRD < 10-4 [0.01%]) within the first 2 cycles, Phase 2 Ph-IIR (Relapsed/Refractory [R/R] Cohort) (Key Secondary) • Duration of response and relapse free survival is defined as the time from the first onset of response (CR/CRh within the first 2 cycles) until hematologic relapse (including EM relapse) or death due to any cause, whichever occurs first, Phase 2 Ph-IIR (Relapsed/Refractory [R/R] Cohort) - • Duration of molecular response is defined as the time from the first onset of molecular response (CR/CRh with MRD < 10-4 [0.01%] within the first 2 cycles) until hematologic relapse (including EM relapse), molecular relapse (MRD ≥ 10-4) or death due to any cause, whichever occurs first, Phase 2 Ph-IIR (Relapsed/Refractory [R/R] Cohort) - • Overall survival (OS) is calculated from the time of the start of first dose of SC blinatumomab until death due to any cause, Phase 2 Ph-IIR (Relapsed/Refractory [R/R] Cohort) - • TEAEs, serious TEAEs, treatment-related TEAEs, and adverse events of interest, Phase 2 Ph-IIR (Relapsed/Refractory [R/R] Cohort) - •Blinatumomab PK parameters following SC administration including, but not limited to Cmax Tmax, and AUC for subjects participating in intense PK sampling assessment •Blinatumomab serum concentrations for subjects not participating in intense PK sampling assessment, Phase 2 Ph-IIR (Relapsed/Refractory [R/R] Cohort) - • Anti blinatumomab antibody formation, Phase 2 Ph-IIR (Relapsed/Refractory [R/R] Cohort) - • Summary scores at each assessment and change from baseline as assessed by the European Organization for Research and Treatment of Cancer (EORTC) Quality of Life Questionnaire (QLQC30) for subjects aged ≥ 17 years at time of assessment and by PedsQL Generic Core Scale for subjects aged 12 to < 17 years at time of consent), Phase 2 Ph-IIR (Relapsed/Refractory [R/R] Cohort) - • Proportion of time on treatment with high side effect bother from baseline to end of treatment as measured by Functional Assessment of Chronic Illness Therapy (FACIT) GP5 item for subjects aged ≥ 17 years at time of consent, Phase 2 Ph-IIR (Relapsed/Refractory [R/R] Cohort) - • Pain difference between pain score before and after injection as reported using the Numeric Rating Scale (NRS-11) for subjects aged 12 to <17 years at time of consent), Phase 2 Ph-IIM (MRD-positive [MRD+] Cohort) (Key Secondary) - Duration of molecular response is defined as the time from the first onset of molecular response (CR with MRD < 10-4 [0.01%] within the first 2 cycles) until hematologic relapse (including EM relapse), molecular relapse (MRD ≥ 10-4) or death due to any cause, whichever occurs first, Phase 2 Ph-IIM (MRD-positive [MRD+] Cohort) (Key Secondary) - CR/CRh with MRD negative response (MRD < 10-4 [0.01%]) within the first 2 cycles - CR/CRh/CRi/Blast free hypoplastic or aplastic BM with MRD negative response (MRD <10 4 [0.01%]) within the first 2 cycles, Phase 2 Ph-IIM (MRD-positive [MRD+] Cohort) - • RFS is defined as the time from first dose of SC blinatumomab until date of the first hematologic relapse (including EM relapse), or death due to any cause, whichever occurs first, Phase 2 Ph-IIM (MRD-positive [MRD+] Cohort) - • OS is calculated from the time of the start of first dose of SC blinatumomab until death due to any cause, Phase 2 Ph-IIM (MRD-positive [MRD+] Cohort) • TEAEs, serious TEAEs, treatment related TEAEs, and adverse events of interest, Phase 2 Ph-IIM (MRD-positive [MRD+] Cohort) - • Anti blinatumomab antibody formation, Phase 2 Ph-IIM (MRD-positive [MRD+] Cohort) - • Summary scores at each assessment and change from baseline as assessed by the EORTC QLQC30 for subjects aged ≥ 17 years at time of consent) and by PedsQL Generic Core Scale for subjects aged 12 to < 17 years at time of consent), Phase 2 Ph-IIM (MRD-positive [MRD+] Cohort) - • Proportion of time on treatment with high side effect bother from baseline to end of treatment as measured by FACIT GP5 item for subjects aged ≥ 17 years at time of consent, Phase 2 Ph-IIM (MRD-positive [MRD+] Cohort) - • Pain difference between pain score before and after injection as reported using the Numeric Rating Scale (NRS-11) for subjects aged 12 to < 17 years at time of consent)

Source: https://euclinicaltrials.eu/ctis-public/view/2023-506136-32-00